EU clinical trial 2025-522573-11-00: Prospective, randomized, double-blind, placebo-controlled, single-center comparative trial evaluating oral hydroxychloroquine 200 mg BID for reducing microglial activation in the brain of patients with progressive multiple sclerosis (MS)
Sponsor: Varsinais-Suomen hyvinvointialue (Hospital/Clinic/Other health care facility). Phase: Therapeutic exploratory (Phase II). Countries: Finland (authorised, recruitment pending).
Therapeutic area(s): Diseases [C] - Immune System Diseases [C20]; Diseases [C] - Nervous System Diseases [C10]
Gender: Female, Male. Age: 18-64 years, 65+ years. Enrolment: 34.
Status: Authorised, recruitment pending. Decision date: 2025-11-20. Results received: No. Last updated: 2026-03-24.

Condition(s): Multiple Sclerosis
Product: Oxiklorin 100 mg tabletti, kalvopäällysteinen, A matching placebo tablet, manufactured by Eurofins BPT FI Oy according to the design of the commercial product will be used.

Primary endpoint: Change in proportion of active voxels in supratentorial cerebral white matter (excluding T1 lesions) in the end-of-treatment TSPO-PET images vs. baseline TSPO-PET images in participants with progressive MS treated with HCQ vs. placebo
Endpoint(s): Change in disease progression as measured with Timed 25 Foot Walk (T25FW), Change in hand dexterity as measured with the 9-Hole Peg Test (9HPT), Change in cognition as measured with symbol digit modalities test (SDMT), Change in health-related quality of life, as measured with the RAND 36-Item Health Survey (RAND-36) and Multiple Sclerosis Impact Scale (MSIS-29) questionnaires, Change in fatigue, as measured with the Modified Fatigue Impact Scale (MFIS) and Fatigue Severity Scale (FSS) questionnaires, Change in MRI volumetric measures in the brain regions of interest, Change in T1 and T2 lesion burden using MRI, Change in number of TSPO-PET-measurable chronic active lesions, Change in proportion of TSPO-PET-detectable active voxels at the rim of chronic lesions (change in proportion of active voxels), Change in proportion of TSPO-PET-detectable active voxels in the NAWM (change in proportion of active voxels), Change in TSPO-PET signal (DVR, distribution volume ratio) at the edges of chronic lesions, Change in TSPO-PET signal (DVR) in the NAWM, Change in axonal damage as measured by serum neurofilament light chain (NfL) levels in blood, Change in astroglial damage as measured by serum glial fibrillary acidic protein (GFAP) levels in blood, Change in number of Quantitative susceptibility mapping (QSM)-positive iron rim lesions, Change in neuroaxonal damage as measured by diffusion tensor imaging (DTI)-MRI parameters, Change in disease progression as measured with Expanded Disability Status Scale (EDSS), Number of Serious Adverse Events

Source: https://euclinicaltrials.eu/ctis-public/view/2025-522573-11-00